EU clinical trial 2024-515353-24-00: GFM-DACORAL-DLI: ASTX727 and donor lymphocyte infusions (DLI) after allogeneic stem cell transplantation (ALLO SCT) in very high-risk MDS or AML patients
Protocol code: GFM-DACORAL-DLI
Sponsor: Groupe Francophone Des Myelodysplasies (Patient organisation/association). Phase: Therapeutic exploratory (Phase II). Countries: France (ended).
Therapeutic area(s): Diseases [C] - Neoplasms [C04]
Gender: Female, Male. Age: 18-64 years, 65+ years. Enrolment: 40.
Status: Ended. Start date (EU): 2021-06-22. End date (EU): 2025-04-22. Decision date: 2024-10-18. Results received: Yes. Last updated: 2024-10-18.

Condition(s): Patients with high risk myelodysplastic syndrome or acute myeloid leukemia
Product: ASTX727

Primary endpoint: DFS at 1 year post transplant
Endpoint(s): Overall survival from the date of transplantation and from the date of inclusion at 1 year and 2 years, Risk factors for DFS, OS NRM at 1 year and 2 years

Source: https://euclinicaltrials.eu/ctis-public/view/2024-515353-24-00